EU clinical trial 2024-517926-25-00: A Phase 1b/2 Open-Label Clinical Study to Evaluate the Safety and Efficacy of MK-6070 and Ifinatamab Deruxtecan (I-DXd) in Participants With Relapsed/Refractory Extensive-Stage Small Cell Lung Cancer
Protocol code: MK-6070-002
Sponsor: Merck Sharp & Dohme LLC (Pharmaceutical company). Phase: Phase I and Phase II (Integrated)- Other. Countries: Spain (ongoing, recruiting).
Therapeutic area(s): Diseases [C] - Neoplasms [C04]
Gender: Female, Male. Age: 18-64 years, 65+ years. Enrolment: 65.
Status: Ongoing, recruiting. Start date (EU): 2025-03-12. Decision date: 2025-03-11. Results received: No. Last updated: 2026-06-17.

Condition(s): Small cell lung cancer
Product: Ifinatamab Deruxtecan, DURVALUMAB, MK-6070, MK-6070

Primary endpoint: Number of Participants Who Experience an Adverse Event (AE), Number of Participants Who Experience One or More Dose-Limiting Toxicities (DLTs), Number of Participants Who Discontinue Study Intervention Due to an AE, Part 1: Objective Response Rate (ORR)
Endpoint(s): Part 1, Part 2 (Arm 5, Arm 6, and Arm 8), and Part 3 (Arm 7): Duration of Response (DOR), Part 1, Part 2 (Arm 6 and Arm 8), and Part 3 (Arm 7): Progression-Free Survival (PFS), Part 2 (Arm 5, Arm 6, and Arm 8) and Part 3 (Arm 7): ORR, Maximum Concentration (Cmax) of gocatamig, Cmax of ifinatamab deruxtecan (I-DXd), Cmax of Anti-B7-H3 Antibody, Cmax of Deruxtecan (DXd), Cmax of durvalumab, Time to maximum concentration (Tmax) of gocatamig, Tmax of I-DXd, Tmax of Anti-B7-H3 Antibody, Tmax of DXd, Area Under the Concentration-Time Curve Over the Dosing Interval t (AUCt) of gocatamig, AUCt of I-DXd, AUCt of Anti-B7-H3 Antibody, AUCt of DXd, erminal Half-Life (t1/2) of gocatamig, t1/2 of I-DXd, t1/2 of Anti-B7-H3 Antibody, t1/2 of DXd, Steady State Maximum Concentration (Cmax,ss) of gocatamig, Cmax,ss of I-DXd, Cmax,ss of Anti-B7-H3 Antibody, Cmax,ss of DXd, Cmax,ss of durvalumab, Steady State Ctrough (Ctrough,ss) of gocatamig, Ctrough,ss of I-DXd, Ctrough,ss of Anti-B7-H3 Antibody, Ctrough,ss of DXd, Ctrough,ss of durvalumab, Steady State Time to Maximum Concentration (Tmax,ss) of gocatamig, Tmax,ss of I-DXd, Tmax,ss of Anti-B7-H3 Antibody, Tmax,ss of DXd, Area Under the Steady State Concentration-Time Curve Over Dosing Interval t (AUCt,ss) of gocatamig, AUCt,ss of I-DXd, AUCt,ss of Anti-B7-H3 Antibody, AUCt,ss of DXd, 39. Steady state t1/2 (t1/2,ss) of gocatamig, t1/2,ss of I-DXd, t1/2,ss of Anti-B7-H3 Antibody, t1/2,ss of DXd, Accumulation Ratio (AC) of gocatamig, AC of I-DXd, AC of Anti-B7-H3 Antibody, AC of DXd, Incidence of Anti-Drug Antibodies (ADAs) Against gocatamig, Incidence of ADAs Against I-DXd, Incidence of ADAs against durvalumab

Source: https://euclinicaltrials.eu/ctis-public/view/2024-517926-25-00